EU clinical trial 2024-515328-35-00: Temporal characterization of Extracellular Vesicles during cellular therapy using CAR-T cells and during the occurrence of Immune effector Cell-Associated Neurotoxicity Syndrome : the VESICANS study
Protocol code: 24CH009
Sponsor: Centre Hospitalier Universitaire De Saint Etienne (Hospital/Clinic/Other health care facility). Phase: Therapeutic use (Phase IV). Countries: France (ongoing, recruiting).
Therapeutic area(s): Phenomena and Processes [G] - Cell Physiological Phenomena [G04]; Phenomena and Processes [G] - Immune system processes [G12]; Diseases [C] - Hemic and Lymphatic Diseases [C15]
Gender: Female, Male. Age: 18-64 years, 65+ years. Enrolment: 60.
Status: Ongoing, recruiting. Start date (EU): 2025-07-02. Decision date: 2024-09-10. Results received: No. Last updated: 2025-04-17.

Condition(s): hematology
Product: Breyanzi 1.1-70 × 106 cells/mL / 1.1-70 × 106 cells/mL dispersion for infusion, YESCARTA 0.4 – 2 x 10e8 cells dispersion for infusion, Abecma 260 - 500 x 10^6 cells dispersion for infusion, GADOVIST 1,0 mmol/mL, solution injectable, Kymriah 1.2 x 10^6 – 6 x 10^8 cells dispersion for infusion, Tecartus 0.4 - 2 x 10e8 cells dispersion for infusion

Primary endpoint: Quantification and characterization endothelial EVs.
Endpoint(s): Quantification and characterization of other EVs subtypes as a function of time before and after treatment with CAR-T cells according to ICANS grade., Quantification and characterization of EVs according to the presence of an ICANS versus no ICANS., Quantification and characterization of EVs according to levels of cytokines., Quantification and structural and molecular characterization of EVs after treatment with CAR-T cells in cerebrospinal fluid (CSF) if available., Characterization of the association of subpopulations of EVs according to clinical neurological impairment and the presence or absence of a sleep apnea syndrome., Characterization of the association of EVS subpopulations according to cognitive assessment and MRI before lymphodepleting chemotherapy and at the time of ICANS., Description of involvement on MRI before lymphodepleting chemotherapy and at the time of ICANS.

Source: https://euclinicaltrials.eu/ctis-public/view/2024-515328-35-00